EU clinical trial 2023-507389-15-00: A Phase II, Open-Label, Multicenter, Randomized Study of the Efficacy and Safety of RO7198457 in Combination With Pembrolizumab Versus Pembrolizumab in Patients with Previously Untreated Advanced Melanoma
Protocol code: GO40558
Sponsor: Genentech Inc. (Pharmaceutical company). Phase: Therapeutic exploratory (Phase II). Countries: Spain (ended), Germany (ended).
Therapeutic area(s): Diseases [C] - Neoplasms [C04]
Gender: Female, Male. Age: 18-64 years, 65+ years. Enrolment: 60.
Status: Ended. Start date (EU): 2020-02-26. End date (EU): 2025-01-21. End date: 2025-01-22. Decision date: 2024-05-23. Results received: Yes. Last updated: 2024-08-20.
Decision dates by country: DE: 2024-06-04, ES: 2024-05-23

Condition(s): Advanced Melanoma
Product: RO7198457, KEYTRUDA 25 mg/mL concentrate for solution for infusion

Primary endpoint: 1. Progression Free Survival
Endpoint(s): 1. Objective Response Rate, 2. Overall Survival, 3. Duration of Response, 4. Mean change from baseline in Health-Related Quality of Life (HRQoL) scores as assessed through use of the two-item Global Health Status (GHS)/HRQoL subscale (Questions 29 and 30) of the European Organisation for Research and Treatment of Cancer Quality of Life-Core 30 (EORTC QLQ-C30) at specified timepoints, 5. Incidence and severity of adverse events, with severity determined according to National Cancer Institute Common Terminology Criteria for Adverse Events, Version 5.0 (NCI CTCAE v5.0), 6. Change from baseline in targeted vital signs, 7. Change from baseline in targeted clinical laboratory test results

Source: https://euclinicaltrials.eu/ctis-public/view/2023-507389-15-00